EU clinical trial 2024-511392-15-00: An interventional, open-label, phase III study to evaluate the safety, efficacy, and impact on quality of life of capivasertib alongside standard-of-care endocrine treatment in patients with HR+/HER2- advanced breast cancer and progression on prior endocrine-based treatment (CAPIcorn)
Protocol code: WSG-AM14
Sponsor: WSG Westdeutsche Studiengruppe GmbH (Pharmaceutical company). Phase: Therapeutic confirmatory (Phase III). Countries: Belgium (ongoing, recruiting), Germany (ongoing, recruiting), Portugal (ongoing, recruiting).
Therapeutic area(s): Diseases [C] - Neoplasms [C04]
Gender: Female, Male. Age: 18-64 years, 65+ years. Enrolment: 250.
Status: Ongoing, recruiting. Start date (EU): 2025-11-20. Decision date: 2025-05-15. Results received: No. Last updated: 2026-02-20.
Decision dates by country: BE: 2025-05-15, DE: 2025-05-15, PT: 2025-05-16

Condition(s): HR+/HER2- advanced breast cancer
Product: TRUQAP 200 mg film-coated tablets, TRUQAP 160 mg film-coated tablets

Primary endpoint: Superiority* of TTNT1 in patients receiving capivasertib compared to an evidence-based “standard TTNT1 curve” for patients without capivasertib., Superiority* of PRO-adherence compared to non-adherence regarding TTDQoL (aka DQoL-free interval).
Endpoint(s): PFS: defined by either: evidence of disease progression as assessed by treating physician or death, OS, Superiority of eHealth support (and summary statistics) regarding TTDQoL compared to patients entering the trial without eHealth support., Multivariable analysis including factors that could contribute to ePRO-adherence., Among patients with eHealth support: Multivariable mediation analysis (PRO-non-adherence as a mediating factor for DQoL) controlling for clinical factors., Among patients without eHealth support: multivariable analysis of impact of clinical factors on DQoL., Evaluation of prophylactic and reactive treatments for AESI management, TTTD, ePROs, AE with CTCAE v5 grade 3+4, AESI-rates, ADR-, SADR-, and SAE-rates, Physician-reported AESI and kind of prophylactic and reactive treatments for AESI management, Physician-reported AESI, prophylactic and reactive treatments for AESI management and TTNT1, Patient-reported tolerability with physician-reported AESI and AESI management, Selected PROs (symptom clusters), Selected clinical endpoints, Self-documented symptoms, Socio-demographic data, Time to Next Treatment 2 (TTNT2), Time to Discontinuation 2 (TTTD2), Progression Free Survival 2 (PFS2)

Source: https://euclinicaltrials.eu/ctis-public/view/2024-511392-15-00